EU clinical trial 2023-508734-34-00: IMPAHCT: A Phase 2b/3, Randomized, Double-Blind, Placebo-Controlled, 24-Week Dose Ranging and Confirmatory Study to Evaluate the Safety and Efficacy of AV-101 in Patients with Pulmonary Arterial Hypertension (PAH)
Protocol code: AV-101-002
Sponsor: Aerovate Therapeutics Inc. (Pharmaceutical company). Phase: Phase II and Phase III (Integrated). Countries: Czechia (ended), Ireland (ended), Poland (ended), Latvia (ended), Portugal (ended), Greece (ended), Germany (ended), Spain (ended), Austria (ended), Sweden (ended), Netherlands (ended), Belgium (ended), Italy (ended), France (ended).
Therapeutic area(s): Diseases [C] - Cardiovascular Diseases [C14]
Gender: Female, Male. Age: 18-64 years, 65+ years. Enrolment: 205.
Status: Ended. Start date (EU): 2022-06-30. End date (EU): 2024-07-18. End date: 2024-08-09. Decision date: 2024-03-04. Results received: Yes. Last updated: 2024-05-23.
Decision dates by country: AT: 2024-04-08, BE: 2024-03-28, CZ: 2024-03-04, FR: 2024-03-07, DE: 2024-03-07, GR: 2024-05-23, IE: 2024-03-05, IT: 2024-03-15, LV: 2024-03-04, PT: 2024-03-05, ES: 2024-04-01, SE: 2024-03-04, NL: 2024-03-06, PL: 2024-03-12

Condition(s): Pulmonary Arterial Hypertension (PAH)
Product: Placebo

Primary endpoint: Primary Endpoint (Phase 2b): Placebo corrected change from baseline at Week 24 in PVR, Primary Endpoint (Phase 3): Placebo corrected change from baseline at Week 24 in the 6MWD
Endpoint(s): Secondary Endpoint (Phase 2b): Change from baseline at Week 24 in NT-proBNP, Secondary Endpoint (Phase 2b): Change from baseline at Week 24 in 6MWD, Secondary Endpoint (Phase 2b): Incidence of Clinical Worsening events, Secondary Endpoint (Phase 2b): Improvement at Week 24 in WHO Functional Class, Secondary Endpoint (Phase 2b): Change in REVEAL Lite 2.0 risk score, Secondary Endpoint (Phase 2b): Change from baseline at Week 24 in QoL, Secondary Endpoint (Phase 3): Change from baseline at Week 24 in NT-proBNP, Secondary Endpoint (Phase 3): Time to Clinical Worsening events, Secondary Endpoint (Phase 3): Improvement at Week 24 in WHO Functional Class, Secondary Endpoint (Phase 3): Change in REVEAL Lite 2.0 risk score, Secondary Endpoint (Phase 3): Change from baseline at Week 24 in QoL

Source: https://euclinicaltrials.eu/ctis-public/view/2023-508734-34-00